EU clinical trial 2024-519552-93-00: A SINGLE-ARM, OPEN-LABEL, PHASE I STUDY TO DETERMINE THE SAFETY, TOLERABILITY, AND PRELIMINARY EFFICACY OF OBE-CEL IN PARTICIPANTS WITH REFRACTORY PROGRESSIVE FORMS OF MULTIPLE SCLEROSIS
Protocol code: AUTO1-MS1
Sponsor: Autolus Limited (Pharmaceutical company). Phase: Human Pharmacology (Phase I)- Other. Countries: Spain (ongoing, recruiting).
Therapeutic area(s): Diseases [C] - Immune System Diseases [C20]
Gender: Female, Male. Age: 18-64 years. Enrolment: 5.
Status: Ongoing, recruiting. Start date (EU): 2025-11-03. Decision date: 2025-06-26. Results received: No. Last updated: 2026-06-11.

Condition(s): Refractory Progressive Multiple Sclerosis

Source: https://euclinicaltrials.eu/ctis-public/view/2024-519552-93-00